EU clinical trial 2022-501429-19-00: CMV preemptive therapy in high-risk immunocompetent major heart surgery patients. A multicenter, double blind, randomized, clinical trial (GAN-CAR).
Protocol code: FIBHGM-ECNC002-2021
Sponsor: Fundacion Para La Investigacion Biomedica Del Hospital Gregorio Maranon (Hospital/Clinic/Other health care facility). Phase: Therapeutic confirmatory (Phase III). Countries: Spain (ended).
Therapeutic area(s): Diseases [C] - Virus Diseases [C02]
Gender: Female, Male. Age: 18-64 years, 65+ years. Enrolment: 226.
Status: Ended. Start date (EU): 2023-09-19. End date (EU): 2025-07-07. Decision date: 2023-01-10. Results received: Yes. Last updated: 2023-12-20.

Condition(s): Cytomegalovirus in high-risk immunocompetent major heart surgery.
Product: Oral solution: Purified water, Methyl Parahydroxybenzoate (Nipagin), Propyl Parahydroxybenzoate(Nipasol)., GANCICLOVIR, VALGANCICLOVIR, Physiological saline: solution for itravenous infusion use.

Primary endpoint: Number of days of good outcome during the 30 days follow-up. A good outcome implies that the patient is alive, out of the ICU, with no systemic antimicrobials, no mechanical ventilation, and no SAEs.
Endpoint(s): Predictive value (specificity, sensibility, cut-off point and area under the curve [AUC]) of Quantiferon-CMV and other immunological markers (total lymphocyte count, CD4/CD8, NK cells, IL-6 and IL-8 levels, serum Immunoglobulin levels) in prediction the presence of viremia., Description of immunologic parameters and their ability (specificity, sensibility, cut-off point and AUC) to predict the development of CM infection., Comparation of immunological parameters between investigational and placebo groups at inclusion (day 0), end of treatment (day 14) and end of study (day 30)., Quantification of the following variables: total lymphocyte count, CD4/CD8, NK cells, IL-6 and IL-8 levels, serum Immunoglobulin levels and its correlation with the viral load., Quantification of Cmin and Cmax (CMV peak and trough viral load in blood) and their correlation with toxicity (AE, SAEs, etc.) Exclusive for PK substudy population., Number of grade 3 or higher AEs related to antiviral drugs.

Source: https://euclinicaltrials.eu/ctis-public/view/2022-501429-19-00